EU clinical trial 2023-507164-39-00: OPTION – OutPatienT InductiON: Labour induction in an outpatient setting - a multicentre randomized controlled trial
Sponsor: Vaestra Goetalandsregionen, University Of Gothenburg (Hospital/Clinic/Other health care facility, Educational Institution). Phase: Therapeutic use (Phase IV). Countries: Sweden (ongoing, recruiting).
Therapeutic area(s): Diseases [C] - Female Urogenital Diseases and Pregnancy Complications [C13]
Gender: Female. Age: 18-64 years. Enrolment: 8891.
Status: Ongoing, recruiting. Start date (EU): 2021-12-01. Decision date: 2023-10-23. Results received: No. Last updated: 2026-06-10.

Condition(s): Induction of labour
Product: Angusta 25 mikrogram tabletter

Primary endpoint: Safety defined as a composite outcome of severe perinatal morbidity or mortality, Efficacy defined as proportion of women with vaginal delivery
Endpoint(s): Pregnancy and delivery-related outcomes (including safety, e.g. mother admitted to the intensive care unit, post-partum bleeding >1000 ml, proportion of women delivered vaginally within 24 or 48 hours from start of induction as well as for the children, e.g. the different variables being part of the primary safety composite outcome will be studied individually in form of exploratory analyses). These secondary end points are descriptive and obtained via registry data., Woman and partner's experience of self-efficacy, health-related quality of life, pain catastrophizing, anxiety and depression; women and partners' experience of childhood experiences and levels of breastfeeding; women and partners' experience as per qualitative interviews, Understanding of healthcare staff's experience of outpatient vs inpatient induction of low-risk pregnancies, Cost-effectiveness, Future pregnancy outcome

Source: https://euclinicaltrials.eu/ctis-public/view/2023-507164-39-00